EU clinical trial 2023-507839-38-00: A study to investigate the pharmacokinetics of a combined oral contraceptive when given alone and in combination with GSK3036656 in female participants of non-childbearing potential aged 18 to 65 years of age
Protocol code: 220104
Sponsor: Glaxosmithkline Research & Development Limited (Pharmaceutical company). Phase: Human Pharmacology (Phase I)- Other. Countries: Spain (ended).
Therapeutic area(s): Diseases [C] - Bacterial Infections and Mycoses [C01]
Gender: Female. Age: 18-64 years, 65+ years. Enrolment: 20.
Status: Ended. Start date (EU): 2024-04-05. End date (EU): 2024-07-01. End date: 2024-07-02. Decision date: 2024-02-23. Results received: No. Last updated: 2024-06-21.

Condition(s): Tuberculosis

Source: https://euclinicaltrials.eu/ctis-public/view/2023-507839-38-00